EU clinical trial 2024-519891-17-00: Debut of Ulcerative Colitis: selective Top-down strategy - the DUCT trial
Sponsor: Universitetssykehuset Nord-Norge HF (Hospital/Clinic/Other health care facility). Phase: Therapeutic exploratory (Phase II). Countries: Norway (authorised, recruitment pending).
Therapeutic area(s): Diseases [C] - Digestive System Diseases [C06]
Gender: Female, Male. Age: 18-64 years, 65+ years. Enrolment: 200.
Status: Authorised, recruitment pending. Decision date: 2025-06-19. Results received: No. Last updated: 2025-06-19.

Condition(s): Ulcerative colitis
Product: AMGEVITA 40 mg solution for injection in pre-filled pen

Primary endpoint: Primary outcome Main Study: Percentage of patients in deep remission 1 year after debut (defined as Mayo score ≤2, endoscopic Mayo score =0, and RHI <3., Sub-study: Percentage of patients who starts with biological medication or undergo surgical intervention during det first year after debut of disease
Endpoint(s): Secondary outcomes: Patient reported outcomes (IBD-QoL, SCCAI), evaluate change in scores from baseline. Medical expenditures based on retrospective questionnaire and medical records review., Secondary endpoint: Patient reported outcomes (IBD-QoL, SCCAI), evaluate change in scores from baseline. Medical expenditures based on retrospective questionnaire and medical records review after 3 years., Exploratory outcomes: Improvement of the proposed biosignature based on data from all 200 included subjects.

Source: https://euclinicaltrials.eu/ctis-public/view/2024-519891-17-00